EU clinical trial 2023-507944-35-00: A Phase 2a multi-center, randomized, double-blind, placebo-controlled study to evaluate the efficacy and safety of Burfiralimab (hzVSF-v13) added to disease-modifying antirheumatic drugs in patient with moderate to severe Rheumatoid Arthritis
Protocol code: hzVSF_V13-0015
Sponsor: Immunemed Inc. (Pharmaceutical company). Phase: Therapeutic exploratory (Phase II). Countries: Spain (ended), Austria (ended), Czechia (ended), Poland (ended), Netherlands (ended), Hungary (ended).
Therapeutic area(s): Diseases [C] - Immune System Diseases [C20]; Diseases [C] - Musculoskeletal Diseases [C05]
Gender: Female, Male. Age: 18-64 years, 65+ years. Enrolment: 67.
Status: Ended. End date (EU): 2024-06-11. Decision date: 2024-04-16. Results received: No. Last updated: 2024-04-22.
Decision dates by country: AT: 2024-04-22, CZ: 2024-04-16, HU: 2024-04-18, ES: 2024-04-16, NL: 2024-04-18, PL: 2024-04-22

Condition(s): rheumatoid arthritis
Product: Burfiralimab, NORMAL SALINE (0.9% NACL)

Primary endpoint: Proportion of participants achieving clinical response according to the American College of Rheumatology (ACR) 20 criteria at Week 12
Endpoint(s): Clinical response at Week 12, assessed as the percentage of participants achieving low disease activity (LDA) as measured by: o ACR50 (70) = 50% (70%) improvement in the ACR core set values o Disease Activity Score 28 for Rheumatoid Arthritis with C-reactive protein (DAS28-CRP) <3.2 o Clinical Disease Activity Index (CDAI) ≤10, Clinical response at Week 12, assessed as the percentage of participants attaining remission as measured by: o DAS28-CRP ≤2.6 o CDAI ≤2.8, Clinical response at Week 12, assessed as (mean) change from Baseline in: o DAS28-CRP o CDAI, Clinical response at Week 12, assessed as the (mean) hybrid ACR score, Improvement in physical function at Week 12, assessed as the percentage of participants with: o A ≥0.22 decrease in patient reported ACR Core Set Values in participant’s assessment of physical function using Health Assessment Questionnaire-Disability Index (HAQ-DI) o A <0.5 in participant’s assessment of physical function using the HAQ DI, Pain relief at Week 12, assessed by the (mean) change from Baseline of the 11 point numeric scale (NRS 11), Health-related quality of life at Week 12 as assessed by (mean) change from baseline of the EQ-5D-5L Health Questionnaire (EuroQoL)

Source: https://euclinicaltrials.eu/ctis-public/view/2023-507944-35-00